EU clinical trial 2024-512841-17-00: A TQT Study to Investigate the Effect of Enpatoran on Cardiac Repolarization in Healthy Participants
Protocol code: MS200569_0065
Sponsor: Merck Healthcare KGaA (Pharmaceutical company). Phase: Human Pharmacology (Phase I)- Other. Countries: Germany (ended).
Therapeutic area(s): Diseases [C] - Immune System Diseases [C20]
Gender: Female, Male. Age: 18-64 years. Enrolment: 40.
Status: Ended. Start date (EU): 2024-09-04. End date (EU): 2024-12-02. Decision date: 2024-07-17. Results received: No. Last updated: 2024-10-16.

Condition(s): Healthy

Source: https://euclinicaltrials.eu/ctis-public/view/2024-512841-17-00